EU clinical trial 2023-508787-29-00: NeoAdjuvant Dynamic marker - Adjusted Personalized Therapy comparing sacituzumab govitecan versus sacituzumab govitecan+pembrolizumab in low-risk, triple-negative early breast cancer (ADAPT-TN-III)
Protocol code: WSG-AM13
Sponsor: WSG Women's Cancer Study Group GmbH (Pharmaceutical company). Phase: Therapeutic exploratory (Phase II). Countries: Germany (ongoing, recruiting).
Therapeutic area(s): Diseases [C] - Neoplasms [C04]
Gender: Female, Male. Age: 18-64 years, 65+ years. Enrolment: 348.
Status: Ongoing, recruiting. Start date (EU): 2024-10-10. Decision date: 2024-03-28. Results received: No. Last updated: 2026-08-05.

Condition(s): Triple-negative early breast cancer with low risk for recurrence
Product: Trodelvy 200 mg powder for concentrate for solution for infusion, KEYTRUDA 25 mg/mL concentrate for solution for infusion

Primary endpoint: The two primary endpoints are: • pCR defined as no invasive tumour in breast and lymph nodes (ypT0/is, ypN0) • 3-year iDFS, defined as time from date of randomization to any invasive breast cancer event, death, or secondary malignancy according to STEEP 2.0 criteria
Endpoint(s): Clinical response measured by palpation, ultrasound, and mammography, OS defined as time from date of first diagnosis to death, OS defined as time from randomization to death, iDFS, dDFS, dDFI, RFS, LRFS, BCFI, Change of health-related quality of life between baseline and after defined timepoints: after 2, 4, and 6 cycles (if applicable), before surgery, every 6 months in follow-up until year 3 and yearly afterwards

Source: https://euclinicaltrials.eu/ctis-public/view/2023-508787-29-00